EU clinical trial 2025-523620-44-02: BudapestICIVasc: Cardiovascular side effects of immune checkpoint inhibitor oncological therapies and their monitoring in the context of onco-cardiology
Sponsor: Semmelweis University (Educational Institution). Phase: Therapeutic use (Phase IV). Countries: Hungary (ongoing, recruiting).
Therapeutic area(s): Diseases [C] - Neoplasms [C04]
Gender: Female, Male. Age: 18-64 years, 65+ years. Enrolment: 1000.
Status: Ongoing, recruiting. Start date (EU): 2026-01-20. Decision date: 2026-01-14. Results received: No. Last updated: 2026-01-14.

Condition(s): non small cell lung cancer (NSCLC), renal cell carcinoma, small cell lung cancer (SCLC), tumors of the head and neck region, bladder carcinoma, malignant melanoma
Product: IMFINZI 50 mg/mL concentrate for solution for infusion, YERVOY 5 mg/ml concentrate for solution for infusion, OPDIVO 10 mg/mL concentrate for solution for infusion., Tecentriq 1 200 mg concentrate for solution for infusion, KEYTRUDA 25 mg/mL concentrate for solution for infusion.

Primary endpoint: The primary endpoint is defined as a 5-point MACE composite endpoint, which includes the following events: • cardiovascular death, • non-fatal myocardial infarction, • non-fatal stroke, • unstable angina requiring hospitalization and/or urgent coronary revascularization, • hospitalization due to heart failure.
Endpoint(s): For a detailed assessment of the cardiovascular safety of the treatment, the following events will be analyzed as secondary endpoints: • newly developing or worsening arterial hypertension; • cardiac arrhythmias; • venous thromboembolic events; • other clinically relevant cardiovascular adverse events; • hospitalization for cardiac reasons, if not part of the MACE composite event defined as the primary endpoint

Source: https://euclinicaltrials.eu/ctis-public/view/2025-523620-44-02